EU clinical trial 2023-504527-40-00: Bioequivalence of Etonogestrel 68 mg Implant in Healthy Pre-Menopausal, Nonpregnant Female Subjects.
Protocol code: BLCL-ETN-FDA-02
Sponsor: Laboratorios Leon Farma S.A. (Pharmaceutical company). Phase: Human Pharmacology (Phase I)- Bioequivalence Study. Countries: Portugal (ended).
Therapeutic area(s): Not possible to specify
Gender: Female. Age: 18-64 years. Enrolment: 80.
Status: Ended. Start date (EU): 2023-06-29. End date (EU): 2024-08-24. Decision date: 2023-06-07. Results received: No. Last updated: 2024-02-21.

Condition(s): No medical condition

Source: https://euclinicaltrials.eu/ctis-public/view/2023-504527-40-00